EU clinical trial 2025-521940-39-00: Phase 2 Trial to determine the efficacy of belumosudil for patients with steroid-refractory overlap of syndrome Graft-versus-Host-Disease (SR-osGVHD) - BEAT-GVHD
Protocol code: 1240 - BEAT-GVHD
Sponsor: Medical Center - University Of Freiburg (Hospital/Clinic/Other health care facility). Phase: Therapeutic exploratory (Phase II). Countries: Germany (ongoing, recruiting).
Therapeutic area(s): Diseases [C] - Immune System Diseases [C20]
Gender: Female, Male. Age: 18-64 years, 65+ years. Enrolment: 24.
Status: Ongoing, recruiting. Start date (EU): 2026-01-20. Decision date: 2025-12-05. Results received: No. Last updated: 2025-12-05.

Condition(s): steroid-refractory overlap syndrom Graft-versus-Host-Disease
Product: SAR445761 - belumosudil

Primary endpoint: Assessment by ORR at the week 25 (Cycle 7 Day 1) visit. The ORR is defined as the proportion of patients demonstrating a CR or PR without the requirement of additional systemic therapies for an earlier progression, mixed response or non-response. Scoring of response will be relative to the organ score at the time of baseline assessment. Missing values will be counted as non-responders
Endpoint(s): FFS is defined as time from start of treatment to the earliest recurrence of underlying disease, start of a new systemic treatment for osGVHD, or death, or the date the patient is last seen alive without event (censored observation), To evaluate change in the mLSS (Symptom control). Response defined as a ≥7-point reduction from baseline in total symptom score (evaluation at week 25)., OS is defined as time from start of treatment to the date of death from any cause, or the date the patient is last seen alive (censored observation), BOR - Proportion of patients who achieved OR (CR+PR) at any time point (up to Cycle 7 day 1 or the start of additional systemic therapy for osGVHD), DOR is assessed for responders only. DOR is defined as the time from first response until osGVHD progression, death, or the date of change/addition of systemic therapies for osGVHD, or the date the patient is last seen alive without event (censored observation), NRM is defined as the time from start of treatment to date of death not preceded by underlying disease relapse/recurrence. Underlying disease relapse/ recurrence is considered as a competing event, Response according to organs; Scoring of response will be relative to the organ score at the time of baseline assessment, To assess the proportion of patients with ≥50% reduction in daily steroid dose at week 25, To assess the proportion of patients who successfully tapered off all steroids at week 25, MR is defined as the time from start of treatment to hematologic malignancy relapse/recurrence. Calculated for patients with underlying hematologic malignant disease. NRM is considered as a competing event., Time to response is defined as time from treatment start to the date of first documentation of PR or CR. Death without prior response will be considered to be a competing event., Changes in immune cell phenotype (T cells (CD3, CD4 and CD8), NK cells (CD56, CD3-, TCR-), NKT cells (CD3+ CD1d Tetramer+), monocytes (CD11bCD14); neutrophils (CD11b, CD15)) B cells (CD21low) and immune metabolism during treatment as described in section 7.6.16., Change in FACT-BMT from baseline to each visit where measured., The AE and SAE reporting and documentation period begins with the ICF signature and ends 30 days after last treatment with belumosudil, further information see section 10., The incidence of AEs defined by preferred term (PT) according to MedDRA will be calculated and analysed.

Source: https://euclinicaltrials.eu/ctis-public/view/2025-521940-39-00